EU clinical trial 2024-518347-38-00: A Multicenter, Two-arm, Double-blind, Double dummy, Parallel-group Study for efficacy and safety evaluation of prolonged release formulation of Betahistine PR 48 mg once daily in comparison with conventional release formulation of Betahistine IR 24 mg, twice daily in treatment of adult patients with Menière's disease
Protocol code: 0796-19
Sponsor: Intas Pharmaceuticals Limited (Pharmaceutical company). Phase: Therapeutic confirmatory (Phase III). Countries: Spain (authorised, recruiting).
Therapeutic area(s): Diseases [C] - Otorhinolaryngologic Diseases [C09]
Gender: Female, Male. Age: 18-64 years, 65+ years. Enrolment: 328.
Status: Authorised, recruiting. Start date (EU): 2022-06-08. Decision date: 2024-10-18. Results received: No. Last updated: 2026-07-13.

Condition(s): Menière's disease
Product: Betahistine dihydrochloride, BETASERC 24 mg, comprimé

Primary endpoint: Percentage of significant responders defined as those patients who present a maximum increase of 1 point in two of the intensity, duration or frequency of vertigo attacks score based on GISFaV scale against baseline score registered during patient inclusion., GISFaV self-rating scale involving each item separately for determination of the disturbance stage of vertigo using values of intensity (V: 4-point scale), duration (D: A 5-point scale) and associated symptoms (N: A 3-point scale), frequency of crisis (F: A 5-point scale), quality of life (Q: A 3-point scale) scored respectively.
Endpoint(s): Number of asymptomatic days (no vertigo attacks) during treatment period., Patient rates with all the GISFaV items equal to 0 at 3 months., Change in number of monthly vertigo attacks during treatment period., Data of rescue medications used during treatment period, Percentage of significant responders defined by 1-point change in any two of intensity, duration and frequency of vertigo attacks score based on GISFaV scale against baseline score registered during patient inclusion in the subgroups of naive patients or pretreated patient with betahistine IR <48 mg/day, The Dizziness Handicap Inventory (DHI) rating scale for the identification of the difficulties that patients encounter during the vertiginous disease., Hearing will be scored as: 'good', 'slightly impaired', 'moderately impaired' or 'seriously impaired'. In addition, the patient will be asked to note whether s/he felt that her/his hearing was 'better', 'the same' or 'worse' than the week before or was 'fluctuating'., Tinnitus will be scored as: 'none', 'mild', 'moderate' or 'severe'., Pressure sensation will be scored as 'none', 'mild', 'moderate' or 'severe'., At the end of the study, the investigators’ and patients’ overall judgments respectively on treatment efficacy and acceptance (five-point scale: 0= null, 1= poor, 2= moderate, 3= good, 4= very good) and the doctor’s preparedness to treat the patient again with the same treatment

Source: https://euclinicaltrials.eu/ctis-public/view/2024-518347-38-00